EU clinical trial 2025-521647-20-00: A research study looking into blood levels of the medicine NNC0487 0111 in the body and how well it is tolerated in people with reduced liver function and normal liver function
Protocol code: NN9490-8156
Sponsor: Novo Nordisk A/S (Pharmaceutical company). Phase: Human Pharmacology (Phase I)- Other. Countries: Slovakia (ongoing, recruiting).
Therapeutic area(s): Not possible to specify
Gender: Female, Male. Age: 18-64 years. Enrolment: 35.
Status: Ongoing, recruiting. Start date (EU): 2026-05-12. Decision date: 2026-04-27. Results received: No. Last updated: 2026-05-14.

Condition(s): hepatic impairment

Source: https://euclinicaltrials.eu/ctis-public/view/2025-521647-20-00